EU clinical trial 2023-508423-13-00: AVO-CLL: a phase III multicenter, randomized, open-label, clinical trial comparing efficacy and safety of acalabrutinib in combination with obinutuzumab versus venetoclax in combination with obinutuzumab in the first-line treatment of newly diagnosed patients with chronic lymphocytic leukemia
Protocol code: AVO CLL
Sponsor: Specjalistyczny Szpital Im. Dra Alfreda Sokolowskiego (Hospital/Clinic/Other health care facility). Phase: Therapeutic confirmatory (Phase III). Countries: Poland (ongoing, recruiting).
Therapeutic area(s): Diseases [C] - Neoplasms [C04]
Gender: Female, Male. Age: 18-64 years, 65+ years. Enrolment: 72.
Status: Ongoing, recruiting. Start date (EU): 2024-07-01. Decision date: 2024-04-02. Results received: No. Last updated: 2025-07-18.

Condition(s): Chronic lymphocytic leukemia
Product: Venclyxto 50 mg film-coated tablets, Calquence 100 mg hard capsules, Venclyxto 100 mg film-coated tablets, Venclyxto 10 mg film-coated tablets, Gazyvaro 1,000 mg concentrate for solution for infusion.

Primary endpoint: Primary endpoint Progression-free survival (PFS), defined as the time from randomization to progression or death, a clinically important endpoint.
Endpoint(s): Secondary endpoints Response to treatment (including MRD), time to next line of treatment. The amount of change in quality of life. Treatment safety based on the assessment of adverse events. Overall survival is defined as the time from randomization to death from any cause.

Source: https://euclinicaltrials.eu/ctis-public/view/2023-508423-13-00